EU clinical trial 2023-504209-35-00: A Phase III, Double-Blinded, Multicenter, Randomized Study Evaluating the Efficacy and Safety of Neoadjuvant Treatment with Atezolizumab or Placebo in Combination with Platinum-Based Chemotherapy in Patients With resectable Stage II, IIIA, or Select IIIB Non-Small Cell Lung Cancer
Protocol code: GO40241
Sponsor: F. Hoffmann-La Roche AG (Pharmaceutical company). Phase: Therapeutic confirmatory (Phase III). Countries: Spain (ended), France (ended), Slovenia (ended), Sweden (ended), Austria (ended), Germany (ended), Poland (ended), Italy (ended).
Therapeutic area(s): Diseases [C] - Neoplasms [C04]
Gender: Female, Male. Age: 18-64 years, 65+ years. Enrolment: 207.
Status: Ended. Start date (EU): 2018-04-04. End date (EU): 2025-12-31. End date: 2026-01-01. Decision date: 2024-02-28. Results received: No. Last updated: 2026-01-13.
Decision dates by country: ES: 2024-02-28, IT: 2024-03-11, SE: 2024-03-04, SI: 2024-02-28, AT: 2024-03-04, DE: 2024-02-28, PL: 2024-03-08, FR: 2024-03-04

Condition(s): Early-Stage Resectable Non-small cell lung cancer (NSCLC)
Product: Tecentriq Placebo, Abraxane 5 mg/ml powder for dispersion for infusion., Tecentriq 1 200 mg concentrate for solution for infusion, ALIMTA 500 mg powder for concentrate for solution for infusion, Gemcitabine 38 mg/ml Concentrate for Solution for Infusion, Carboplatin 10 mg/ml Intravenous Infusion, Cisplatin 1mg/ml concentrate for solution for infusion

Primary endpoint: IRF-assessed EFS
Endpoint(s): 1. IRF-assessed pCR, 2. IRF-assessed MPR, 3. MPR and pCR, as assessed by the investigator site pathology laboratory, 4. Objective response by the investigator according to RECIST v1.1, 5. OS, 6. Investigator-assessed EFS, 7. DFS as determined by the investigator, 8. 2-year and 3-year OS, IRF assessed EFS and investigator-assessed EFS, 9. Change from baseline in health-related quality of life (HRQoL) scores as assessed through use of the two-item global health status (GHS)/ QoL subscale (Questions 29 and 30) of the European Organisation for Research and Treatment of Cancer Quality-of-Life Questionnaire Core 30 at each assessment time point during the study through the completion of adjuvant treatment and observation follow up assessments, 10. Occurrence and severity of adverse events, including serious adverse events and immune-related adverse events, with severity determined according to NCI CTCAE v5.0, 11. Incidence and length of surgical delays, incidence of operative and post-operative complications, and/or reasons for surgical cancellations, 12. Serum concentration of atezolizumab at specified timepoints, 13. Incidence of anti-drug antibodies (ADAs) against atezolizumab during the study

Source: https://euclinicaltrials.eu/ctis-public/view/2023-504209-35-00